EU clinical trial 2024-517315-69-00: Vaginal administration of selective estrogen receptor modulator (Tamoxifen) treatment to improve sexual function for women with breast cancer. A randomized, double-blinded, placebo controlled longitudinal phase 3 study.
Protocol code: 1
Sponsor: Uppsala University (Educational Institution). Phase: Therapeutic confirmatory (Phase III). Countries: Sweden (authorised, recruitment pending).
Therapeutic area(s): Diseases [C] - Female Urogenital Diseases and Pregnancy Complications [C13]
Gender: Female. Age: 18-64 years, 65+ years. Enrolment: 120.
Status: Authorised, recruitment pending. Decision date: 2024-08-30. Results received: No. Last updated: 2024-08-30.

Condition(s): Vulvovaginal atrophy symptoms
Product: TAMOXIFEN, ATC-kod V03AX10. Hittas ej av systemet.

Primary endpoint: The primary endpoint will be captured by a modified version of the Endocrine Subscale-FACT-B, a validated 5-point response scale (not at all/minor/moderate/considerable/severe) developed for breast cancer research
Endpoint(s): Change from baseline to week 12 in all subscales of the modified version of the Endocrine Subscale-FACT-B. Change from baseline to week 12 in total score on the Female Sexual Function Index (FSFI). Change from baseline to week 12 in total score on the Female Sexual Distress Scale-revised (FSDS-R). Change from baseline to Week 12 in Quality of Life. Information will be collected using the EORTC QLQ-C30

Source: https://euclinicaltrials.eu/ctis-public/view/2024-517315-69-00